EU clinical trial 2024-519076-75-00: TryptoBPH - Proof-of-concept study to evaluate the safety and efficacy of tryptophan in patients with BPH
Protocol code: TryptoBPH
Sponsor: CCAB Centro Clinico Academico Braga Associacao (Pharmaceutical company). Phase: Therapeutic exploratory (Phase II). Countries: Portugal (temporarily halted).
Therapeutic area(s): Diseases [C] - Neoplasms [C04]; Diseases [C] - Male Urogenital Diseases [C12]
Gender: Male. Age: 18-64 years, 65+ years. Enrolment: 70.
Status: Temporarily halted. Start date (EU): 2024-12-05. Decision date: 2024-11-07. Results received: No. Last updated: 2025-04-30.

Condition(s): Benign prostatic hyperplasia
Product: Omnic 0,4 mg, comprimidos de libertação prolongada, revestidos por película, Cincofarm 100 mg Cápsulas

Primary endpoint: Change from baseline in the total score (questions 1–7) of the IPSS questionnaire
Endpoint(s): Urine maximum flow rate (Qmax); Erectile function, assessed by International Index of Erectile Function-5 (IIEF-5); and prostate volume (in cc), assessed by trans-rectal ultra-sound; and in quality of life due to urinary symptoms (question 8 of the IPSS)

Source: https://euclinicaltrials.eu/ctis-public/view/2024-519076-75-00